EU clinical trial 2024-513441-36-00: A Phase 2, open label, randomized study of neoadjuvant dostarlimab plus CAPEOX versus CAPEOX in participants with previously untreated T4N0 or Stage III MMRp/ MSS colon cancer
Protocol code: 222892
Sponsor: Glaxosmithkline Research & Development Limited (Pharmaceutical company). Phase: Therapeutic exploratory (Phase II). Countries: Belgium (ongoing, recruiting), Spain (ongoing, recruiting), Italy (ongoing, recruiting).
Therapeutic area(s): Diseases [C] - Digestive System Diseases [C06]; Diseases [C] - Neoplasms [C04]
Gender: Female, Male. Age: 18-64 years, 65+ years. Enrolment: 170.
Status: Ongoing, recruiting. Start date (EU): 2024-11-27. Decision date: 2024-11-06. Results received: No. Last updated: 2025-12-18.
Decision dates by country: IT: 2025-04-24, ES: 2024-11-25, BE: 2024-12-16

Condition(s): MMRp/ MSS colon cancer
Product: CAPECITABINE ZENTIVA 150 mg, comprimé pelliculé, Capecitabine Accord 150 mg film-coated tablets, Oxaliplatin Bendalis 5 mg/ml Konzentrat zur Herstellung einer Infusionslösung, Oxaliplatin AqVida 5 mg/ml Konzentrat zur Herstellung einer Infusionslösung, Capecitabin "Zentiva", filmovertrukne tabletter, Capecitabina Zentiva 500 mg compresse rivestite con film., Capecitabine Zentiva 150 mg filmdragerade tabletter, Capecitabin "Zentiva", filmovertrukne tabletter, CAPECITABINE ZENTIVA 150 mg, comprimé pelliculé, JEMPERLI 500 mg concentrate for solution for infusion, Capecitabine Accord 500 mg film-coated tablets

Primary endpoint: Proportion of participants with major pathological response determined by local assessment with protocol specific training/methods, defined as≤10% RVT., Frequency and severity of treatment emergent AEs, SAEs, imAEs, and AEs leading to death or discontinuation of study intervention.
Endpoint(s): Proportion of participants for whom primary tumour resection is not excluded by either: o Disease progression precluding surgery. o Treatment related toxicity that results in the participant not being suitable for surgery., Proportion of participants with pathological response determined by local assessment in the following categories: o Complete pathologic response (cPR) (0% RVT) o Major pathological response excluding cPR (>0% & ≤10% RVT) o Partial pathologic response (>10% & ≤50% RVT) o Negligible pathologic response (>50% RVT)

Source: https://euclinicaltrials.eu/ctis-public/view/2024-513441-36-00